EU clinical trial 2024-519980-16-00: Efficacy and safety of the intratracheal administration of budesonide with surfactant in very preterm infants to prevent bronchopulmonary dysplasia: randomized clinical trial.
Protocol code: BuS2020
Sponsor: Fundacio De Recerca Clinic Barcelona-Institut D’Investigacions Biomediques August Pi I Sunyer (Laboratory/Research/Testing facility). Phase: Therapeutic confirmatory (Phase III). Countries: Spain (ended).
Therapeutic area(s): Diseases [C] - Congenital, Hereditary, and Neonatal Diseases and Abnormalities [C16]; Diseases [C] - Respiratory Tract Diseases [C08]
Gender: Female, Male. Age: 0-17 years. Enrolment: 60.
Status: Ended. End date (EU): 2026-05-26. Decision date: 2025-01-08. Results received: No. Last updated: 2025-01-08.

Condition(s): Bronchopulmonary dysplasia, Preterm newborns ≤32 weeks of gestational age.
Product: Budesonida Aldo-Unión 0,5 mg/ml suspensión para inhalación por nebulizador, CUROSURF® 120mg/vial + 240mg/vial Endotracheopulmonary Instillation Suspension

Primary endpoint: Efficacy: Lung ultrasound LAS and IL-6 concentration in nasopharyngeal aspirate on day 7 of life., Safety: Nosocomial sepsis (defined as a positive blood culture in a patient >72 hours of life), gastrointestinal perforation, death (cause and age).
Endpoint(s): Lung ultrasound LAS on days 3, 14, 21, and 28 of life and 36 weeks PMA or prior to discharge., IL-6 concentration in nasopharyngeal aspirate on day 28 of life., Days of oxygen and respiratory support at 28 days of life and 36 weeks PMA or prior to discharge., Incidence of BPD at 28 days and 36 weeks PMA or prior to discharge., Adverse effects of budesonide., Neurodevelopmental assessment at 2 years of life: using the Bayley III test, which evaluates cognitive, visual, fine and gross motor skills, memory, receptive and expressive language, and processing speed., Evaluation of respiratory outcomes at 2 years of life: Need and duration of home oxygen therapy, maintenance corticosteroid or bronchodilator treatment, diagnosis of pulmonary hypertension, number of hospital admissions due to respiratory causes, and details of the underlying cause.

Source: https://euclinicaltrials.eu/ctis-public/view/2024-519980-16-00